EU clinical trial 2023-504513-77-00: JAKAHDI - JAK inhibitors in acquired hemophagocytic syndrome in the ICU
Protocol code: APHP220919
Sponsor: Assistance Publique Hopitaux De Paris (Hospital/Clinic/Other health care facility). Phase: Therapeutic exploratory (Phase II). Countries: France (ended).
Therapeutic area(s): Diseases [C] - Hemic and Lymphatic Diseases [C15]
Gender: Female, Male. Age: 18-64 years, 65+ years. Enrolment: 42.
Status: Ended. Start date (EU): 2024-09-16. End date (EU): 2026-03-03. Decision date: 2023-10-10. Results received: No. Last updated: 2026-02-25.

Condition(s): Adult patients older than 18 years. Patients admitted to the participating ICUs will be included in this study if the meet eligibility criteria.
Product: DEXAMETHASONE, Jakavi 5 mg tablets, ETOPOSIDE, METHYLPREDNISOLONE

Primary endpoint: The primary end point will be survival with a decrease in SOFA score ≥ 3 points at day 7.
Endpoint(s): - Overall survival in HS critically ill patients, - Temperature, SOFA score and biological (ferritin level, CD25 soluble receptor dosage, fibrinogen level, triglycerides level, hemoglobin level, white blood cells count, platelets count) manifestations related to HS, - To analyse biological inflammatory markers (IL2, IL6, IL10, IL12, GM-CSF, IFN gamma, TNF alpha), - Safety of ruxolitinib in critically ill HS patients

Source: https://euclinicaltrials.eu/ctis-public/view/2023-504513-77-00